EU clinical trial 2024-519492-25-01: Comparison of transanal irrigation and glycerol suppositories in treatment of Low Anterior Resection Syndrome
Sponsor: Region Midtjylland (Hospital/Clinic/Other health care facility). Phase: Phase III and phase IV (Integrated). Countries: Denmark (ended).
Therapeutic area(s): Diseases [C] - Digestive System Diseases [C06]
Gender: Female, Male. Age: 18-64 years, 65+ years. Enrolment: 114.
Status: Ended. Start date (EU): 2019-07-24. End date (EU): 2026-04-13. Decision date: 2025-01-10. Results received: No. Last updated: 2025-01-10.

Condition(s): Low Anterior Resection Syndrome
Product: Glycerol "OBA", suppositorier

Primary endpoint: The primary endpoint will be change of the main symptom score assessed by the Measure Yourself Medical Outcome Profile (MYMOP) score comparing the TAI group to the glycerol suppository group.
Endpoint(s): 1. Assessment of bowel function with the LARS Score (27) and the Memorial Sloan-Kettering Cancer Centre (MSKCC) Bowel Function Instrument (BFI) (28)). 2. Assessment of the faecal incontinence status with The St. Mark’s Incontinence Score (29). 3. Assessment of QOL and bowel function-related QOL with the EORTC QLQ-C30 and EORTC QLQ-CR29 (30,31). 4. Assessment of urinary function with The International Consultation on Incontinence Questionnaire Male/Female Lower Urinary Tract Symptoms (ICIQ-M/F-L

Source: https://euclinicaltrials.eu/ctis-public/view/2024-519492-25-01